EU clinical trial 2025-523881-26-00: Identification of mitochondrial biomarkers reflecting omaveloxolone treatment (in FA patients)
Protocol code: MITO-FA
Sponsor: Fakultni Nemocnice V Motole (Hospital/Clinic/Other health care facility). Phase: Therapeutic use (Phase IV). Countries: Czechia (ongoing, recruiting), Poland (authorised, recruitment pending).
Therapeutic area(s): Diseases [C] - Nervous System Diseases [C10]
Gender: Female, Male. Age: 18-64 years, 65+ years. Enrolment: 65.
Start date (EU): 2026-05-27. Decision date: 2026-03-30. Results received: No. Last updated: 2026-04-03.
Decision dates by country: CZ: 2026-03-30, PL: 2026-04-03

Condition(s): Friedreich's ataxia
Product: Skyclarys 50 mg hard capsules

Primary endpoint: Change in mitochondrial biomarkers (lipofuscin-like pigments, PINK1, ULK1, BNIP3L, TFEB, LC3, p62, GPX4, SLC7A11, and 4-HNE) from baseline to 6 and 12 months in patients with FA treated with omaveloxolone.
Endpoint(s): Between-group differences in mitochondrial biomarkers at the 6-month timepoint (treated FA patients vs. controls)., Correlation of biomarker changes with changes in mFARS, SARA, and ADL scores over time.

Source: https://euclinicaltrials.eu/ctis-public/view/2025-523881-26-00